EU clinical trial 2023-506655-19-00: A Phase II, Multicenter Induction Study with an Active Treatment Extension to Evaluate the Efficacy, Safety, and Pharmacokinetics of Vixarelimab in Patients with Moderate to Severe Ulcerative Colitis
Protocol code: GA44839
Sponsor: Genentech Inc. (Pharmaceutical company). Phase: Therapeutic exploratory (Phase II). Countries: Belgium (ended), Germany (ended), France (ended), Italy (ended), Czechia (ended), Greece (ended), Poland (ended).
Therapeutic area(s): Diseases [C] - Digestive System Diseases [C06]
Gender: Female, Male. Age: 18-64 years, 65+ years. Enrolment: 138.
Status: Ended. Start date (EU): 2024-05-16. End date (EU): 2025-06-16. End date: 2025-06-17. Decision date: 2024-04-23. Results received: Yes. Last updated: 2025-07-14.
Decision dates by country: DE: 2024-04-26, IT: 2024-04-29, BE: 2024-04-23, GR: 2024-04-29, PL: 2024-04-29, CZ: 2024-04-24, FR: 2024-04-25

Condition(s): Ulcerative Colitis (UC)
Product: AZATHIOPRINE, ADALIMUMAB, METHOTREXATE, GOLIMUMAB, Vixarelimab, INFLIXIMAB, MERCAPTOPURINE, Vixarelimab Placebo

Primary endpoint: 1. Clinical remission at Week 12, with clinical remission defined as modified Mayo Score (mMS) of ≤ 2, including stool frequency subscore ≤ 1, rectal bleeding subscore = 0, endoscopy subscore ≤ 1
Endpoint(s): 1. Clinical response at Week 12, with clinical response defined as decrease from baseline in the mMS of ≥ 2 and ≥ 30% reduction from baseline, with either a decrease in rectal bleeding subscore of ≥ 1 or absolute rectal bleeding subscore of ≤ 1, 2. Endoscopic improvement at Week 12, with endoscopic improvement defined as a Mayo endoscopy subscore of ≤ 1 (score of 1 modified to exclude friability), 3. Endoscopic remission at Week 12, with endoscopic remission defined as a Mayo endoscopy subscore of 0, 4. Incidence and severity of adverse events, with severity determined according to the DAIDS toxicity grading scale, 5. Serum concentration of vixarelimab at specified timepoints, 6. Prevalence of anti-drug antibodies (ADAs) at baseline and incidence of ADAs during the study

Source: https://euclinicaltrials.eu/ctis-public/view/2023-506655-19-00